EU clinical trial 2025-520868-17-00: Use of 64CuCl2 PET/CT Imaging in the selection of patients with prostate cancer in biochemical relapse after prostatectomy, to be successfully treated with salvage radiotherapy on the prostatic bed.
Protocol code: P.64Cu.002.02
Sponsor: A.C.O.M. Advanced Center Oncology Macerata S.r.l. (Pharmaceutical company). Phase: Therapeutic confirmatory (Phase III). Countries: Italy (authorised, recruitment pending).
Therapeutic area(s): Analytical, Diagnostic and Therapeutic Techniques and Equipment [E] - Diagnosis [E01]; Diseases [C] - Neoplasms [C04]
Gender: Male. Age: 18-64 years, 65+ years. Enrolment: 138.
Status: Authorised, recruitment pending. Decision date: 2025-02-24. Results received: No. Last updated: 2025-09-10.

Condition(s): Cancer on the prostatic bed
Product: 64Cu(II)Cl2 solution for injection

Primary endpoint: To evaluate the relationship between PSA levels (calculated between PSA levels measured before treatment and minimum PSA level measured during the observational period following the treatment) and prostatic bed (positive prostate (B +) and negative prostate (B-). The 64CuCl2-PET is obtained positive (B +) when in the prostate bed a detectable focal absorption is manifested because superior to the value of the background; otherwise it is judged negative (B-).
Endpoint(s): Calculation of the maximum variation of PSA in the subgroups of patients with PSA<0.5 and PSA between 0.5 and 1, through the ROC curve and evaluation of the ability to detect sites of recurrence., In each patient the impact that the positive results of 64CuCl2-PET out of the prostatic bed would have had on the therapeutic choice will be evaluated and tabulated, also taking into account the classification of the patient in R+/R-;, Sensitivity, specificity, positive and negative predictive values and area under the curve (AUC) will be evaluated., The time between treatment beginning (baseline) and the achievement of the minimum value (NADIR) will be estimated through estimates of Kaplan-Meyer curves., The SUV values of the prostate bed index lesions will be correlated with the actual SRT response, in order to identify the SUV limits below which the uptake is not significant., Adverse events will be recorded and classified according to the EMA guidelines.

Source: https://euclinicaltrials.eu/ctis-public/view/2025-520868-17-00